EU clinical trial 2025-522446-51-00: Assessment of the safety and effects on the body of investigational products when used on psoriatic skin
Protocol code: BAP5191-102
Sponsor: Bacoba AG (Pharmaceutical company). Phase: Human Pharmacology (Phase I)- Other. Countries: Germany (ended).
Therapeutic area(s): Diseases [C] - Immune System Diseases [C20]; Diseases [C] - Skin and Connective Tissue Diseases [C17]
Gender: Female, Male. Age: 18-64 years, 65+ years. Enrolment: 15.
Status: Ended. Start date (EU): 2025-10-17. End date (EU): 2026-03-30. End date: 2026-03-31. Decision date: 2025-10-09. Results received: No. Last updated: 2026-03-27.

Condition(s): Plaque psoriasis

Source: https://euclinicaltrials.eu/ctis-public/view/2025-522446-51-00